EU clinical trial 2024-513467-47-00: A Study to Learn How Different Amounts of the Study Medicine Called PF-07940369 are Tolerated and Act in the Body in Healthy Adults.
Protocol code: C5381001
Sponsor: Pfizer Inc. (Pharmaceutical company). Phase: Human Pharmacology (Phase I)- First administration to humans. Countries: Belgium (ended).
Therapeutic area(s): Diseases [C] - Hemic and Lymphatic Diseases [C15]
Gender: Female, Male. Age: 18-64 years, 65+ years. Enrolment: 24.
Status: Ended. Start date (EU): 2024-08-08. End date (EU): 2025-01-16. End date: 2025-01-17. Decision date: 2024-08-05. Results received: No. Last updated: 2024-10-01.

Condition(s): clonal hematopoiesis

Source: https://euclinicaltrials.eu/ctis-public/view/2024-513467-47-00